EU clinical trial 2024-511770-76-00: A First in Human Study of IBC-Ab002 in Persons With Early Alzheimer's Disease (AD)
Protocol code: IBC-01-01
Sponsor: Immunobrain Checkpoint Ltd. (Pharmaceutical company). Phase: Human Pharmacology (Phase I)- First administration to humans. Countries: Netherlands (ended).
Therapeutic area(s): Diseases [C] - Nervous System Diseases [C10]
Gender: Female, Male. Age: 18-64 years, 65+ years. Enrolment: 1.
Status: Ended. Start date (EU): 2023-10-31. End date (EU): 2025-10-21. End date: 2025-12-16. Decision date: 2024-06-28. Results received: No. Last updated: 2025-05-22.

Condition(s): Alzheimer's disease

Source: https://euclinicaltrials.eu/ctis-public/view/2024-511770-76-00